EU clinical trial 2024-514502-31-00: A Prospective, Multicenter, Long-Term Study to Assess the Safety and Efficacy of Nemolizumab (CD14152) in Subjects with Prurigo Nodularis
Protocol code: RD-06-SPR-202699
Sponsor: Galderma S.A. (Pharmaceutical company). Phase: Therapeutic confirmatory (Phase III). Countries: Sweden (ended), Germany (ended), Spain (ended), Denmark (ended), Belgium (ended), Hungary (ended), Poland (ongoing, recruitment ended), France (ended), Netherlands (ended), Austria (ended), Italy (ongoing, recruitment ended).
Therapeutic area(s): Diseases [C] - Skin and Connective Tissue Diseases [C17]
Gender: Female, Male. Age: 18-64 years, 65+ years. Enrolment: 348.
Start date (EU): 2021-01-11. Decision date: 2024-09-18. Results received: No. Last updated: 2025-12-12.
Decision dates by country: HU: 2024-09-18, ES: 2024-09-18, BE: 2024-09-18, DK: 2024-09-20, SE: 2024-09-19, PL: 2024-09-20, NL: 2024-09-18, AT: 2024-10-28, FR: 2024-09-26, IT: 2025-01-09, DE: 2024-09-24

Condition(s): Prurigo Nodularis
Product: Nemolizumab

Primary endpoint: Incidence and severity of adverse events (AEs), including AEs of special interest, treatment-emergent AEs, and serious AEs., For subjects who re-entered from durability study (RD.06.SPR.203890):
Endpoint(s): Proportion of subjects with an IGA success (defined as IGA of 0 [Clear] or 1 [Almost clear]) at each visit up to Week 184, Proportion of subjects with an improvement of ≥4 from baseline in PP NRS up to Week 184, Proportion of subjects with low disease activity state (ie, IGA ≤2) at each visit up to Week 184, Percentage of pruriginous lesions with excoriations/crusts (PAS item 5a) at each visit up to Week 184, Percentage of healed prurigo lesions (PAS item 5b) at each visit up to Week 184, Change from baseline in number of lesions in representative area (PAS item 4) at each visit up to Week 184, Proportion of subjects with PP NRS <2 up to Week 184, Absolute and percent change from baseline in PP NRS up to Week 184, Proportion of subjects with AP NRS <2 up to Week 52, Proportion of subjects with an improvement of ≥4 from baseline in AP NRS up to Week 52, Absolute and percent change from baseline in AP NRS up to Week 52, Proportion of subjects with an improvement of ≥4 from baseline in Sleep Disturbance (SD) NRS up to Week 184, Absolute and percent change from baseline in SD NRS up to Week 184, Change from baseline in PN-associated pain frequency up to Week 184, Change from baseline in PN-associated pain intensity up to Week 184, Proportion of subjects reporting low disease activity (clear, almost clear, or mild) based on Patient Global Assessment of Disease (PGAD) at each visit up to Week 52, Proportion of subjects satisfied with study treatment (good, very good, or excellent) based on Patient Global Assessment of Treatment (PGAT) at each visit up to Week 52, Proportion of subjects with an improvement of ≥4 from baseline in Dermatology Life Quality Index (DLQI) up to Week 184, Change from baseline in EuroQoL 5-Dimension (EQ-5D) up to Week 184, Time to permanent study drug discontinuation, Time to rescue therapy use, Proportion of subjects receiving any rescue treatment by rescue treatment, For subjects who re-entered from durability study (RD.06.SPR.203890): Proportion of subjects with an Investigator Global Assessment (IGA) success (defined as IGA of 0 [Clear] or 1 [Almost clear]) at each visit up to Week R132 by treatment and overall [relapsed, non-relapsed subjects], For subjects who re-entered from durability study (RD.06.SPR.203890): Proportion of subjects with an improvement of ≥4 from re-entry baseline in Peak Pruritus numeric rating scale (PP NRS) up to Week R132 by treatment and overall [relapsed subjects], For subjects who re-entered from durability study (RD.06.SPR.203890): Proportion of subjects with an improvement of ≥4 from baseline in Peak Pruritus numeric rating scale (PP NRS) up to Week R132 by treatment and overall [non-relapsed subjects], For subjects who re-entered from durability study (RD.06.SPR.203890): Proportion of subjects with recapture of clinical response, defined as: Investigator Global Assessment (IGA) success and an improvement of ≥ 4 from re entry baseline in Peak Pruritus numeric rating scale (PP NRS) up to Week R132 by treatment and overall [relapsed subjects], For subjects who re-entered from durability study (RD.06.SPR.203890): Proportion of subjects with maintenance of clinical response, defined as: Investigator Global Assessment (IGA) success and an improvement of ≥4 from baseline in Peak Pruritus numeric rating scale (PP NRS) up to Week R132 by treatment and overall [non-relapsed subjects], For subjects who re-entered from durability study (RD.06.SPR.203890): Proportion of subjects with an improvement ≥4 from baseline in Sleep Disturbance numeric rating scale (SD NRS) up to Week R132 by treatment and overall [relapsed and non-relapsed subjects], For subjects who re-entered from durability study (RD.06.SPR.203890): Proportion of subjects with an improvement ≥4 from baseline in Dermatology Life Quality Index (DLQI) up to Week R132 by treatment and overall [relapsed and non-relapsed subjects], For subjects who re-entered from durability study (RD.06.SPR.203890): Time to recapture of clinical response for relapsed subjects who received placebo in the durability study (RD.06.SPR.203890)

Source: https://euclinicaltrials.eu/ctis-public/view/2024-514502-31-00